EU clinical trial 2022-502081-24-00: A Multiple-Dose Clinical Study to Evaluate Safety, Tolerability, and Pharmacokinetics of MK-8527 in Healthy Participants
Protocol code: MK-8527-005
Sponsor: Merck Sharp & Dohme LLC (Pharmaceutical company). Phase: Human Pharmacology (Phase I)- Other. Countries: Belgium (expired).
Therapeutic area(s): Diseases [C] - Virus Diseases [C02]
Gender: Female, Male. Age: 18-64 years. Enrolment: 28.
Status: Expired. Decision date: 2022-12-14. Results received: No. Last updated: 2022-12-14.

Condition(s): HIV-1 (Human Immunodeficiency Virus Type 1)

Source: https://euclinicaltrials.eu/ctis-public/view/2022-502081-24-00